EU clinical trial 2024-515249-41-00: Umbilical vein catheterization through Wharton’s jelly in the delivery room : CaDOm multicenter clinical trial.
Protocol code: CHRD 2419
Sponsor: Hopital NOVO (Hospital/Clinic/Other health care facility). Phase: Phase II and Phase III (Integrated). Countries: France (ongoing, recruiting).
Therapeutic area(s): Diseases [C] - Congenital, Hereditary, and Neonatal Diseases and Abnormalities [C16]
Gender: Female, Male. Age: 0-17 years. Enrolment: 26.
Status: Ongoing, recruiting. Start date (EU): 2025-10-01. Decision date: 2024-12-30. Results received: No. Last updated: 2026-05-29.

Condition(s): Cardiorespiratory arrest at birth in full-term newborns
Product: ADRENALINE AGUETTANT 1 mg/ml, solution injectable en ampoule

Primary endpoint: Estimate the success rate of cardiopulmonary resuscitation in less than 90 seconds with the VOW procedure as first intention, in newborns with circulatory arrest in the delivery room for whom an adrenaline injection is indicated
Endpoint(s): Duration of placement of the umbilical route through Wharton's jelly (VOW) (delay in seconds between the start of asepsis and the start of the adrenaline injection). To be compared to the KTVO application time (delay between the adrenaline decision and the injection, in order to take into account the KTVO application time) if applicable., Delay in seconds between the start of the VOW procedure and obtaining a heart rate greater than 100 bpm, overall and depending on the approach actually used (compare the delays with VOW procedure versus KTVO procedure if applicable), Delay in seconds between the adrenaline injection and obtaining a heart rate > 100 bpm, overall and depending on the approach actually used (compare the delays with the VOW procedure versus the KTVO procedure if applicable), Frequency of VOW procedure failures: number of failures over the number of attempts, Description of types and causes of failures The types of failures are: time exceeded, ineffective injection or an adverse event. The causes of failures could be: a small bowel cord, coloring/opacity of the cord (icteric or impregnated with meconium), extravasation, failure to locate the vein, absence of reflux, maternal hemorrhage, a hardware-related defect (unsuitable needle, unsuitable syringes), secondary perforation of the vein, inability to hold the needle in the vein, move..., Mortality rate at H1 and at hospital discharge (or at 28 days), overall and according to the approach actually used (number of patients who died out of the number of patients included), Description of adverse events in the 72 hours following the injection, overall and according to the approach actually used (VOW vs KTVO), Modeling (GLM model) of the relationship between, on the one hand, the success or duration of placement and, on the other hand, the state of the cord (normal or abnormal: if abnormal, it can be thin, meconium-opaque or yellow in the context of jaundice) or the experience of the practitioner (number of years of professional experience in neonatal resuscitation and experience of the VOW procedure), Difficulties when implementing this VOW procedure will be collected from healthcare professionals and described. These difficulties could be as follows: a lack of confidence of the caregiver at the time of the procedure, a lack of personnel, a difficulty in visualizing the vein, a defect linked to the equipment, an abnormal cord,... A likert questionnaire will also be asked of caregivers so that they can indicate their feelings about the complexity of the VOW procedure

Source: https://euclinicaltrials.eu/ctis-public/view/2024-515249-41-00